EU clinical trial 2023-509094-23-00: A randomized comparison of one controlled ovarian stimulation with corifollitropin alfa (CFA) versus up to three modified natural cycles (MNC) in expected and established poor responders
Protocol code: MONACO
Sponsor: Universitair Ziekenhuis Gent (Hospital/Clinic/Other health care facility). Phase: Therapeutic use (Phase IV). Countries: Belgium (ongoing, recruiting).
Therapeutic area(s): Phenomena and Processes [G] - Reproductive and Urinary Physiological Phenomena [G08]
Gender: Female. Age: 18-64 years. Enrolment: 300.
Status: Ongoing, recruiting. Start date (EU): 2022-07-15. Decision date: 2024-06-27. Results received: No. Last updated: 2026-04-29.

Condition(s): Subfertility
Product: Puregon 150 IU/0.18 mL solution for injection, Puregon 900 IU/1.08 mL solution for injection, Orgalutran 0.25 mg/0.5 mL solution for injection, Orgalutran 0.25 mg/0.5 mL solution for injection, Puregon 600 IU/0.72 mL solution for injection, Puregon 300 IU/0.36 mL solution for injection, Ovitrelle 250 micrograms/0.5 mL solution for injection in pre-filled syringe, Ovitrelle 250 micrograms/0.5 mL solution for injection in pre-filled syringe, Ovitrelle 250 micrograms/0.5 mL solution for injection in pre-filled syringe, Elonva 150 micrograms solution for injection, Ovitrelle 250 micrograms/0.5 mL solution for injection in pre-filled syringe

Primary endpoint: the probability of having at least one good quality blastocyst after ART (on the day of embryo transfer) (binary endpoint).
Endpoint(s): the relative number of blastocyts after ART (on the day of embryo transfer), relative to the number of oocytes (rate), the probability of having at least one blastocyst of good quality after ART (on the day of embryo transfer) (binary endpoint), the probability of having an ongoing pregnancy which is defined as 6 to 8 weeks gestational age (binary endpoint) o Related sensitivity endpoint:, as confirmed by ultrasound (time to event)

Source: https://euclinicaltrials.eu/ctis-public/view/2023-509094-23-00